EU clinical trial 2024-512212-21-00: A Randomized, Open-label, Multi-center Phase III Study of Durvalumab and Tremelimumab as First-line Treatment in Patients with advanced Hepatocellular Carcinoma (HIMALAYA)
Protocol code: D419CC00002
Sponsor: AstraZeneca AB (Pharmaceutical company). Phase: Therapeutic confirmatory (Phase III). Countries: Spain (ended), Germany (ended), France (ongoing, recruitment ended), Italy (ongoing, recruitment ended).
Therapeutic area(s): Diseases [C] - Neoplasms [C04]
Gender: Female, Male. Age: 18-64 years, 65+ years. Enrolment: 302.
Start date (EU): 2017-11-28. Decision date: 2024-07-12. Results received: No. Last updated: 2026-05-18.
Decision dates by country: ES: 2024-07-12, DE: 2024-08-08, IT: 2024-07-22, FR: 2024-07-22

Condition(s): Advanced hepatocellular carcinoma (HCC)
Product: IMFINZI 50 mg/mL concentrate for solution for infusion., IMJUDO 20 mg/ml concentrate for solution for infusion., Mycophenolate Mofetil 500 mg film-coated tablets, Nexavar 200 mg film-coated tablets, Inflectra 100 mg powder for concentrate for solution for infusion

Primary endpoint: Overall survival (OS) is defined as the time from the date of randomization until death due to any cause.
Endpoint(s): Progression-free survival (PFS), Time to progression (TTP), Objective response rate (ORR), Disease control rate (DCR), and Duration of response (DoR)

Source: https://euclinicaltrials.eu/ctis-public/view/2024-512212-21-00